EU clinical trial 2024-518028-63-00: Maternal Mental Health (MAMA) Study. Short time estrogen as a candidate strategy to prevent postpartum depression in a high-risk group
Protocol code: 2020-001592-33
Sponsor: Rigshospitalet (Hospital/Clinic/Other health care facility). Phase: Therapeutic exploratory (Phase II). Countries: Denmark (ongoing, recruitment ended).
Therapeutic area(s): Psychiatry and Psychology [F] - Mental Disorders [F03]
Gender: Female, Male. Age: 0-17 years, 18-64 years. Enrolment: 220.
Status: Ongoing, recruitment ended. Start date (EU): 2024-10-08. Decision date: 2024-10-08. Results received: No. Last updated: 2026-03-06.

Condition(s): Perinatal depression with postpartum onset
Product: Vivelle Dot 100 mikrogram/24 timer, depotplaster., Placebo is Comfeel Plus Transparent from Coloplast. The Comfeel Plus Transparent is a thin and flexible hydrocolloid dressing. https://www.coloplast.dk/comfeel-plus-transparent-da-dk.aspx#section=product-description_3

Primary endpoint: Clinical depression according to DSM-V criteria. Between 2 weeks and 6 months postpartum

Source: https://euclinicaltrials.eu/ctis-public/view/2024-518028-63-00